EU clinical trial 2024-515021-29-00: A Randomized, Placebo-Controlled, Double-Blind, Single Dose, Phase 1 Study to Explore the PK/PD Relationship of QRL-101 in People Living With ALS
Protocol code: QRL-101-04
Sponsor: Quralis Corp. (Pharmaceutical company). Phase: Human Pharmacology (Phase I)- Other. Countries: Netherlands (ended).
Therapeutic area(s): Diseases [C] - Nervous System Diseases [C10]
Gender: Female, Male. Age: 18-64 years, 65+ years. Enrolment: 12.
Status: Ended. Start date (EU): 2024-11-11. End date (EU): 2025-08-22. Decision date: 2024-10-14. Results received: No. Last updated: 2025-05-01.

Condition(s): Amyotrophic lateral sclerosis (ALS)

Source: https://euclinicaltrials.eu/ctis-public/view/2024-515021-29-00